EU clinical trial 2024-514407-33-00: A Participant- and Investigator-blind, Randomised, Placebo controlled Phase II Study to Evaluate Safety, Tolerability, and Mucosal Repair with AZD7798 in Patients with Active Ileal Crohn’s Disease and an Ileostomy (CALLISTO)
Protocol code: D9690C00006
Sponsor: AstraZeneca AB (Pharmaceutical company). Phase: Therapeutic exploratory (Phase II). Countries: Sweden (ongoing, recruitment ended), Poland (ended), Belgium (ongoing, recruitment ended), Italy (ongoing, recruitment ended), Netherlands (ended).
Therapeutic area(s): Diseases [C] - Immune System Diseases [C20]
Gender: Female, Male. Age: 18-64 years, 65+ years. Enrolment: 27.
Start date (EU): 2024-12-10. Decision date: 2024-11-04. Results received: No. Last updated: 2026-07-28.
Decision dates by country: NL: 2025-02-10, SE: 2024-11-04, PL: 2025-01-27, BE: 2025-01-16, IT: 2025-01-24

Condition(s): Crohn’s Disease and an Ileostomy
Product: AZD7798 Placebo: 0.9% saline solution for injection, commercially available., AZD7798

Primary endpoint: Safety and tolerability evaluations using AEs, clinical laboratory assessments, vital sign measures, and 12 lead ECGs.
Endpoint(s): Safety and tolerability evaluations using AEs, clinical laboratory assessments, vital sign measures, and 12 lead ECGs since week12 to week 52., a) Change from baseline in Simple Endoscopic Score for Crohn’s Disease (SES CD using endoscopic assessment) at Week 12 b) Change from baseline in Modified Multiplier of SES-CD (MM SES-CD) at Week 12. c) Endoscopic response (≥ 50% decrease from baseline in SES-CD total score) at Week 12. d) Endoscopic remission (SES-CD total score < 4 and at least 2‑point reduction from baseline with no subscore > 1 at Week 12., a) Serum AZD7798 concentration. b) Incidence and titre of ADA response

Source: https://euclinicaltrials.eu/ctis-public/view/2024-514407-33-00